EU clinical trial 2025-521443-20-00: A randomized, double-blind, placebo-controlled study of daridorexant treatment in adolescents with enuresis: proof-of-concept.
Sponsor: Region Midtjylland (Hospital/Clinic/Other health care facility). Phase: Therapeutic confirmatory (Phase III). Countries: Denmark (authorised, recruiting).
Therapeutic area(s): Diseases [C] - Male Urogenital Diseases [C12]; Diseases [C] - Female Urogenital Diseases and Pregnancy Complications [C13]
Gender: Female, Male. Age: 0-17 years. Enrolment: 20.
Status: Authorised, recruiting. Start date (EU): 2026-03-11. Decision date: 2025-07-18. Results received: No. Last updated: 2025-07-18.

Condition(s): Nocturnal enuresis
Product: QUVIVIQ 25 mg film-coated tablets, Convex tablet coated with DB Caps®, size B, Gray Opaque from Lonza Capsugel.

Primary endpoint: Change in wet nights/week.
Endpoint(s): Nocturnal urine production., Bladder capacity (maximum voided volume)., Nocturnal bladder capacity., Adverse events., Termination of the treatment., Number of participants with full- and partial response

Source: https://euclinicaltrials.eu/ctis-public/view/2025-521443-20-00